EU clinical trial 2023-509131-12-01: A phase II trial aiming to investigate the safety and clinical activity of belantamab mafodotin in adult patients with primary immune thrombocytopenia previously treated with a thrombopoietin receptor agonist and/or rituximab after corticosteroid first-line therapy - BONSAI
Protocol code: EAE140
Sponsor: Hellenic Society Of Hematology (Patient organisation/association). Phase: Therapeutic exploratory (Phase II). Countries: Greece (ongoing, recruiting).
Therapeutic area(s): Diseases [C] - Hemic and Lymphatic Diseases [C15]
Gender: Female, Male. Age: 18-64 years, 65+ years. Enrolment: 14.
Status: Ongoing, recruiting. Start date (EU): 2025-09-30. Decision date: 2025-02-11. Results received: No. Last updated: 2026-02-17.

Condition(s): Primary Immune Thrombocytopenia

Primary endpoint: Complete response rate (CRR)/Partial response rate (PRR) at 6 months of treatment.
Endpoint(s): Patients with treatment-emergent adverse events (AEs) and serious AEs., Overall response rate at 2, 6 and 12 months., Complete response rate at 12 months., Time to response (TTR), Duration of response (DoR)., ORR., Number of participants with abnormal ocular findings (on ophthalmic exam)., Belantamab mafodotin dose holds., Number and proportion of participants with changes from baseline in ocular symptoms and related impacts as measured by the Vision Related Anamnestic Tool

Source: https://euclinicaltrials.eu/ctis-public/view/2023-509131-12-01